EU clinical trial 2023-505255-51-00: A phase 3b, open-label, multi-country, multi-centre, long-term follow-up study of ZOSTER-049 (follow- up of ZOSTER-006/022 studies) to assess the prophylactic efficacy, safety and persistence of immune response of a Herpes Zoster subunit vaccine and assessment of persistence of immune response and safety of 1 or 2 additional doses administered in ZOSTER-049 in 2 subgroups of older adults.
Protocol code: 217917
Sponsor: GlaxoSmithKline Biologicals (Pharmaceutical company). Phase: Therapeutic confirmatory (Phase III). Countries: Sweden (ongoing, recruitment ended), Finland (ongoing, recruitment ended), Estonia (ongoing, recruitment ended), France (ongoing, recruitment ended), Spain (ongoing, recruitment ended), Czechia (ongoing, recruitment ended), Germany (ongoing, recruitment ended), Italy (ongoing, recruitment ended).
Therapeutic area(s): Diseases [C] - Immune System Diseases [C20]; Diseases [C] - Virus Diseases [C02]
Gender: Female, Male. Age: 18-64 years, 65+ years. Enrolment: 2157.
Status: Ongoing, recruitment ended. Start date (EU): 2022-08-08. Decision date: 2023-11-06. Results received: No. Last updated: 2026-08-07.
Decision dates by country: FI: 2023-11-08, DE: 2023-11-10, EE: 2023-11-06, CZ: 2023-11-16, FR: 2023-11-07, IT: 2023-12-01, ES: 2023-11-06, SE: 2023-11-08

Condition(s): Herpes Zoster
Product: Shingrix powder and suspension for suspension for injection Herpes zoster vaccine (recombinant, adjuvanted)

Primary endpoint: Confirmed HZ cases during the total duration of the ZOSTER-101 study (Day 1 through Month 48).
Endpoint(s): Confirmed HZ cases since 1-month post Dose 2 in the ZOSTER-006/022 studies until the end of the ZOSTER- 101 study., Anti-gE antibody concentrations at Day 1*, Months 12, 24, 36 and 48 in ZOSTER-101 study., Frequency of gE-specific CD4+ T-cells secreting at least 2 activation markers (from among IFN-γ, IL-2, TNF-α, CD40L) at Day 1*, Months 12, 24, 36 and 48 in ZOSTER-101 study., Number and percentage of participants with SAEs which are assessed as causally related to the study intervention by the investigator during the total duration of the ZOSTER-101 study (Day 1 through Month 48)., Number and percentage of participants with pIMDs (serious and non-serious) which are assessed as causally related to the study intervention by the investigator during the total duration of the ZOSTER- 101 study (Day 1 through Month 48)., Number and percentage of participants with HZ-related complications of confirmed HZ during the total duration of the ZOSTER-101 study (Day 1 through Month 48).

Source: https://euclinicaltrials.eu/ctis-public/view/2023-505255-51-00